EU clinical trial 2023-503298-39-00: A Phase III, Two- Arm, Parallel, Randomized, Multi-Center, Open‑Label, Global Study to Determine the Efficacy of Volrustomig (MEDI5752) in Combination with Chemotherapy Versus Pembrolizumab Plus Chemotherapy for First-Line Treatment of Patients with Metastatic Non-Small Cell Lung Cancer (mNSCLC) (eVOLVE-Lung02)
Protocol code: D798AC00001
Sponsor: AstraZeneca AB (Pharmaceutical company). Phase: Therapeutic confirmatory (Phase III). Countries: Netherlands (temporarily halted), Hungary (temporarily halted), Austria (temporarily halted), Slovakia (temporarily halted), Spain (temporarily halted), Germany (temporarily halted), Italy (temporarily halted), Poland (temporarily halted), Czechia (temporarily halted), Belgium (temporarily halted), France (temporarily halted).
Therapeutic area(s): Diseases [C] - Neoplasms [C04]
Gender: Female, Male. Age: 18-64 years, 65+ years. Enrolment: 437.
Status: Temporarily halted. Start date (EU): 2024-06-13. Decision date: 2024-01-25. Results received: No. Last updated: 2026-04-20.
Decision dates by country: AT: 2024-01-29, PL: 2024-06-03, BE: 2024-01-29, SK: 2024-01-25, IT: 2024-06-04, CZ: 2024-06-04, DE: 2024-01-25, NL: 2024-01-29, FR: 2024-06-04, ES: 2024-06-03, HU: 2024-01-25

Condition(s): Metastatic Non-Small Cell Lung Cancer (mNSCLC)
Product: volrustomig, KEYTRUDA 25 mg/mL concentrate for solution for infusion, Carboplatin Hikma 10 mg/ml Konzentrat zur Herstellung einer Infusionslösung, Paclitaxel Bendalis 6 mg/ml Konzentrat zur Herstellung einer Infusionslösung, Pemetrexed Accord 25 mg/ml concentrate for solution for infusion, Mycofit, 250 mg, kapsułki twarde, Remsima 100 mg powder for concentrate for solution for infusion

Primary endpoint: Progression-Free Survival (PFS) in PD-L1 <1% (using BICR assessments according to RECIST 1.1); PFS is defined as the time from randomization until radiological progression per RECIST 1.1 as assessed by BICR, or death due to any cause (in the absence of progression). The analysis will include all randomized participants where PD-L1 <1%., Overall Survival (OS) in PD-L1 <1%; OS is defined as the time from randomization until the date of death due to any cause. The analysis will include all randomized participants where PD-L1 < 1%.
Endpoint(s): Overall survival in all randomized patients, Progression Free Survival in all randomized participants.

Source: https://euclinicaltrials.eu/ctis-public/view/2023-503298-39-00